EU clinical trial 2024-516976-14-00: A Phase I/II, Modular, Open-Label, Multi-Centre Study to Evaluate the Safety, Pharmacokinetics, Pharmacodynamics, and Preliminary Efficacy of AZD9750 as Monotherapy and in Combination with Other Anticancer Agents in Participants with Metastatic Prostate Cancer (ANDROMEDA)
Protocol code: D7270C00001
Sponsor: AstraZeneca AB (Pharmaceutical company). Phase: Phase I and Phase II (Integrated)- First administration to humans. Countries: Netherlands (authorised, recruiting), Spain (authorised, recruiting).
Therapeutic area(s): Diseases [C] - Male Urogenital Diseases [C12]
Gender: Male. Age: 18-64 years, 65+ years. Enrolment: 52.
Status: Authorised, recruiting. Start date (EU): 2026-06-12. Decision date: 2026-03-30. Results received: No. Last updated: 2026-04-15.
Decision dates by country: ES: 2026-03-31, NL: 2026-03-30

Condition(s): Metastatic Prostate Cancer
Product: AZD9750, Saruparib

Primary endpoint: Part A and B (Safety): Incidence of DLTs (Part A), Part A and B (Safety): Incidence of AEs, SAEs, Part A and B (Safety): AEs leading to discontinuation of study intervention, Part A and B (Safety): Clinically significant changes from baseline in vital signs, physical examination, ECOG PS, ECGs and laboratory parameters., Part B only (Efficacy): Proportion of participants achieving a ≥ 50% decrease in PSA from baseline.
Endpoint(s): For Part A and B (Efficacy): Proportion of participants achieving a ≥ 50% decrease in PSA from baseline (Part A)., For Part A and B (Efficacy): Proportion of participants achieving a ≥ 90% decrease in PSA from baseline., For Part A and B (Efficacy): ORR, DoR, TTR, rPFS assessed by the Investigator according to RECIST v1.1 (soft tissue) and PCWG3 (bone) criteria., For Part A and B (Efficacy): Best percentage change in TL size from baseline using RECIST v1.1., For Part A and B (Efficacy): Time to PSA response and Time to PSA progression according to PCWG3 criteria., For Part A and B (PK): Plasma concentrations and PK parameters including, but not limited to Cmax, tmax and AUC after oral administration of AZD9750, if data allows.

Source: https://euclinicaltrials.eu/ctis-public/view/2024-516976-14-00